EU clinical trial 2025-520970-21-00: Hemodynamic safety of isobaric levobupivacaine versus isobaric bupivacaine for subarachnoid anesthesia in patients over 65 years old undergoing hip fracture surgery
Protocol code: CoLeBu
Sponsor: Instituto De Investigacion Sanitaria Fundacion Para La Investigacion Del Hospital Clinico De Valencia-INCLIVA (Hospital/Clinic/Other health care facility). Phase: Therapeutic use (Phase IV). Countries: Spain (ongoing, recruitment ended).
Therapeutic area(s): Analytical, Diagnostic and Therapeutic Techniques and Equipment [E] - Anesthesia and Analgesia [E03]
Gender: Female, Male. Age: 65+ years. Enrolment: 150.
Status: Ongoing, recruitment ended. Start date (EU): 2018-06-14. Decision date: 2025-02-04. Results received: No. Last updated: 2025-02-04.

Condition(s): Hip fracture
Product: Levobupivacaína Normon 5 mg/ml solución inyectable y para perfusión EFG, Inibsacain 5 mg/ml + 0,005 mg/ml solución inyectable en cartucho

Primary endpoint: Invasive systolic arterial pressure (PASI), invasive diastolic arterial pressure (PADI), invasive mean arterial pressure (PAMI), arterial oxygen saturation (SatO2) measured in %, heart rate (HR) measured in beats per minute (bpm), and partial oxygen saturation (SpO2%) measured in %.
Endpoint(s): Cardiac index (CI), peripheral vascular resistance (PVR), partial arterial oxygen pressure (PaO2), and partial arterial carbon dioxide pressure (PaCO2) measured in mmHg, pH, arterial lactate (Lc) measured in mmol/L, and arterial hemoglobin (Hb) measured in g/dL., Adverse events during surgery and up to 48 hours after the surgical procedure will include: cardiovascular and respiratory adverse events, associated with the surgical technique and with the anesthetic technique.

Source: https://euclinicaltrials.eu/ctis-public/view/2025-520970-21-00